EU clinical trial 2025-522506-20-00: Flumazenil for Benzodiazepine Reversal in Electroconvulsive Therapy (FLEET): A Randomized Controlled Trial
Sponsor: Region Hovedstaden (Hospital/Clinic/Other health care facility). Phase: Therapeutic use (Phase IV). Countries: Denmark (ongoing, recruiting).
Therapeutic area(s): Diseases [C] - Nervous System Diseases [C10]
Gender: Female, Male. Age: 18-64 years, 65+ years. Enrolment: 145.
Status: Ongoing, recruiting. Start date (EU): 2026-01-07. Decision date: 2025-09-09. Results received: No. Last updated: 2025-09-09.

Condition(s): Depression
Product: FLUMAZENIL

Primary endpoint: Objective cognitive function
Endpoint(s): Clinical response, Subjective cognitive performance, Autobiographical memory function, Executive cognitive function, Separate cognitive domains, Patient satisfaction, Pre-treatment anxiety, Reorientation time, Seizure quality, Brain memory networks

Source: https://euclinicaltrials.eu/ctis-public/view/2025-522506-20-00